EU clinical trial 2023-507015-35-00: Ischemic and bleeding outcomes after angiolite stent implantation and an abbreviated dual antiplatelet therapy. A 2x2 factorial, all-comer, multicenter, randomized controlled trial: ANGIODAPT
Sponsor: Ivascular S.L. (Pharmaceutical company). Phase: Therapeutic confirmatory (Phase III). Countries: Spain (ongoing, recruitment ended), Belgium (ongoing, recruitment ended), France (ongoing, recruitment ended).
Therapeutic area(s): Diseases [C] - Cardiovascular Diseases [C14]
Gender: Female, Male. Age: 18-64 years, 65+ years. Enrolment: 2312.
Status: Ongoing, recruitment ended. Start date (EU): 2023-10-06. Decision date: 2023-10-04. Results received: No. Last updated: 2026-07-15.
Decision dates by country: FR: 2024-06-14, ES: 2023-10-04, BE: 2024-05-24

Condition(s): Coronary Artery Disease
Product: ACETYLSALICYLIC ACID, ACETYLSALICYLIC ACID, CLOPIDOGREL, CLOPIDOGREL, PRASUGREL, TICAGRELOR, PRASUGREL, PRASUGREL, CLOPIDOGREL, TICAGRELOR

Primary endpoint: Rate of target lesion failure, a composite endpoint defined as the occurrence of any of the following events as adjudicated by CEC at 12 month follow-up: cardiovascular death, target-vessel myocardial infarction, or clinically driven target lesion revascularization., Rate of clinically relevant bleeding events at 12 month follow-up defined as Bleeding Academic Research Consortium (BARC) type 2, 3, or 5 events as adjudicated by CEC
Endpoint(s): Rate of any ischemic event at 12 month follow-up defined as the occurrence of any of the following events as adjudicated by CEC: all-cause death, non-fatal myocardial infarction, or stroke., Rate of target lesion failure in the standard-of-care DAPT subgroup, a composite endpoint defined as the occurrence of any of the following events as adjudicated by the CEC at 12 month follow-up in patients receiving standard-of-care dual antiplatelet therapy: cardiovascular death, target-vessel myocardial infarction, or clinically driven target lesion revascularization

Source: https://euclinicaltrials.eu/ctis-public/view/2023-507015-35-00